EU clinical trial 2025-523265-15-00: A Phase 1b, Open-Label, Multicenter Study Evaluating the Safety, Tolerability, Pharmacokinetics, Pharmacodynamics, Immunogenicity, and Preliminary Clinical Activity of CND261 in Patients with Seropositive Rheumatoid Arthritis
Protocol code: CND261-101
Sponsor: Candid Therapeutics Inc. (Pharmaceutical company). Phase: Human Pharmacology (Phase I)- Other. Countries: Romania (ended).
Therapeutic area(s): Diseases [C] - Immune System Diseases [C20]; Diseases [C] - Musculoskeletal Diseases [C05]
Gender: Female, Male. Age: 18-64 years, 65+ years. Enrolment: 9.
Status: Ended. End date (EU): 2026-04-13. Decision date: 2025-12-16. Results received: No. Last updated: 2025-12-16.

Condition(s): Seropositive Rheumatoid Arthritis

Source: https://euclinicaltrials.eu/ctis-public/view/2025-523265-15-00